EU clinical trial 2022-502724-46-00: A Phase 1/2a, Randomized, Placebo-Controlled Study to Evaluate the Safety, Tolerability, Pharmacokinetics, and Antiviral Activity of BJT-778 in Healthy Volunteers and in Subjects with Chronic Hepatitis B Infection, Including Subjects with Chronic Hepatitis D Infection
Protocol code: BJT-778-001
Sponsor: Bluejay Therapeutics Inc. (Pharmaceutical company). Phase: Phase I and Phase II (Integrated)- Other. Countries: Bulgaria (expired), Romania (expired), France (expired).
Therapeutic area(s): Diseases [C] - Virus Diseases [C02]
Gender: Female, Male. Age: 18-64 years, 65+ years. Enrolment: 16.
Status: Expired. Decision date: 2023-07-24. Results received: No. Last updated: 2023-07-24.
Decision dates by country: BG: 2023-07-24, FR: 2023-07-24, RO: 2023-07-24

Condition(s): Chronic Hepatitis B Infection, Chronic Hepatitis D Infection
Product: SODIUM CHLORIDE, BJT-778

Primary endpoint: Incidence of treatment-emergent AEs and clinically significant laboratory abnormalities
Endpoint(s): Determination of Cmax, Clast, Tmax, Tlast, AUCinf, AUClast, t1/2, λz, WF, and CL/F, Proportion of subjects who develop antidrug antibodies (ADAs) and, if detected, impact of ADAs on safety, PK, and pharmacodynamics, Maximum reduction of absolute HBsAg levels from baseline during treatment, Reductions of HBsAg from baseline over time, Maximum reduction of absolute HDV RNA levels from baseline, Reductions in HDV RNA from baseline over time, Proportion who achieves ≥2 log reduction in HDV RNA from baseline or HDV RNA undetectable, Maximum reduction of absolute ALT from baseline and changes of ALT from baseline over time in CHD subjects

Source: https://euclinicaltrials.eu/ctis-public/view/2022-502724-46-00